EU clinical trial 2023-505022-34-00: A Multicenter, Randomized, Double-Blind, Phase 2, Basket Study of MK-4280A, a Coformulation of Favezelimab (MK-4280) with Pembrolizumab (MK-3475) in Selected Solid Tumors (KeyForm-010)
Protocol code: MK-4280A-010
Sponsor: Merck Sharp & Dohme LLC (Pharmaceutical company). Phase: Therapeutic exploratory (Phase II). Countries: France (ended), Italy (ended), Netherlands (ended), Germany (ended).
Therapeutic area(s): Diseases [C] - Neoplasms [C04]
Gender: Female, Male. Age: 18-64 years, 65+ years. Enrolment: 19.
Status: Ended. Start date (EU): 2024-03-27. End date (EU): 2026-03-12. End date: 2026-03-13. Decision date: 2023-10-31. Results received: No. Last updated: 2026-01-28.
Decision dates by country: DE: 2023-11-02, IT: 2023-10-31, FR: 2023-10-31, NL: 2023-11-06

Condition(s): Neoplasm malignant
Product: KEYTRUDA 25 mg/mL concentrate for solution for infusion, Lenvatinib, MK-4280A, Lenvatinib

Primary endpoint: Clinical Benefit - Cohort A, Objective Response Rate (ORR) per Response Evaluation Criteria in Solid Tumors Version 1.1 (RECIST 1.1) as assessed by Investigator – Cohort B
Endpoint(s): Pathologic Complete Response (pCR) – Cohort A, Major Pathologic Response (mPR) - Cohort A, ORR per RECIST 1.1 as assessed by Investigator - Cohort A, Number of participants with an adverse event (AE) - Cohorts A and B, Number of participants discontinuing from study therapy due to AE - Cohorts A and B, Number of participants experiencing perioperative complications - Cohort A, Number of participants with an AE that precludes surgery - Cohort A

Source: https://euclinicaltrials.eu/ctis-public/view/2023-505022-34-00